EU clinical trial 2023-510556-22-00: HOVON 136 NHL: Phase I-II study combining Brentuximab Vedotin with second line salvage chemotherapy (RDHAP) in CD30 positive diffuse large B-cell lymphoma patients refractory to first line chemotherapy or in first relapse who are eligible for high dose treatment followed by autologous stem cell transplantation.
Protocol code: HO136
Sponsor: Hemato-Oncologie voor Volwassenen Nederland (Hovon) Stichting (Hospital/Clinic/Other health care facility). Phase: Therapeutic exploratory (Phase II). Countries: Spain (ongoing, recruitment ended), Belgium (ongoing, recruitment ended), Netherlands (ongoing, recruitment ended).
Therapeutic area(s): Diseases [C] - Hemic and Lymphatic Diseases [C15]
Gender: Female, Male. Age: 18-64 years. Enrolment: 36.
Status: Ongoing, recruitment ended. Start date (EU): 2018-03-05. Decision date: 2024-11-13. Results received: No. Last updated: 2024-11-25.
Decision dates by country: BE: 2024-11-25, ES: 2024-11-13, NL: 2024-11-13

Condition(s): non-Hodgkin lymphoma (NHL), Diffuse large B-cell lymphoma (DLBCL)
Product: ADCETRIS 50 mg powder for concentrate for solution for infusion

Primary endpoint: Phase 1 part: The rate of patients with serious toxicity during cycle 1-2 of the combination BV-R-DHAP. Phase 2 part: 1) Primary efficacy endpoint: Metaftabolic CR rate (PET-diagnostic CT) er the third cycle of BV-R-DHAP salvage therapy. 2) Primary feasibility/toxicity endpoints: Rate of grade 3/4 non-hematological toxicity, including neurotoxicity after each cycle of BV-R-DHAP
Endpoint(s): Phase 1 part: (Serious) Adverse Events during combination treatment, Phase 1 part: Time to hematological recovery after each cycle of BV-R-DHAP, Phase 1 part: Time to recovery from non-hematological toxicity after each cycle of BV-R-DHAP, Phase 1 part: Administration of treatment: dose reductions, interval between cycles, discontinuation rate, Phase 1 part: Rate of successful PBSC collection (≥ 2x106 CD34+ cells/kg) after the third cycle of BV-R-DHAP, Phase 2 part: Overall response rate (PR + CR) after the third cycle of BV-R-DHAP salvage therapy (based on the results of the FDG-PET/CT scan), Phase 2 part: Overall response rate (PR + CR) after ASCT (based on the results of the FDG-PET/CT scan), Phase 2 part: Metabolic CR rate (PET-CT) after ASCT, Phase 2 part: Fraction of patients (CR/PR) eligible for ASCT who actually undergo ASCT, Phase 2 part: Progression free survival (PFS), Event free survival (EFS), Overall survival (OS), Phase 2 part: (Serious) Adverse Events during the combination treatment, Phase 2 part: Time to hematological recovery after each cycle of BV + R-DHAP, Phase 2 part: Administration of treatment: dose reductions, interval between courses, discontinuation rate, Phase 2 part: Rate of successful PBSC collection (≥ 2 x106 CD34+ cells/kg) after the second or third cycle of BV-R-DHAP, Phase 2 part: Time to hematological recovery after ASCT, Phase 2 part: (Serious) Adverse Events after ASCT

Source: https://euclinicaltrials.eu/ctis-public/view/2023-510556-22-00